EU clinical trial 2023-508190-84-01: 68Gallium-FAPI PET/CT imaging in Chronic inflammatory and fibrotic diseases (PARADISE study)
Protocol code: 29BRC23.0029
Sponsor: CHU de Brest (Health care). Phase: Therapeutic exploratory (Phase II). Countries: France (ongoing, recruiting).
Therapeutic area(s): Analytical, Diagnostic and Therapeutic Techniques and Equipment [E] - Investigative Techniques [E05]
Gender: Female, Male. Age: 18-64 years, 65+ years. Enrolment: 390.
Status: Ongoing, recruiting. Start date (EU): 2025-03-13. Decision date: 2024-11-20. Results received: No. Last updated: 2026-06-01.

Condition(s): Inflammatory disorders
Product: GALLIUM (68GA) CHLORIDE, 68-FAPI-46

Primary endpoint: Binding intensity in TEP, measured by the Standardized uptake value (SUV) max.
Endpoint(s): To meet the first secondary objective: - Measurement of fixation intensity in PET and measurement of pathology-specific reference score (if applicable)., To meet the second secondary objective: - Measurement of fixation intensity in PET and measurement of other pathology-specific assessment scores (if applicable), To meet the third secondary objective: - Measurement of PET fixation intensity and measurement of pathology-specific biomarkers (if applicable), To meet the fourth secondary objective: - Measurement of PET fixation intensity and measurement of pathology-specific functional parameters (if applicable), To meet the fifth secondary objective: - Measurement of PET fixation intensity and assessment of pathology-specific imaging characteristics (if applicable), To meet the sixth secondary objective: - Measurement of [68Ga] Ga-FAPI PET/CT fixation intensity and measurement of [18F] F-FDG PET/CT fixation intensity at M0, To address the seventh secondary objective: - Evaluation of [68Ga] Ga-FAPI tracer uptake kinetics in PET according to different pathologies and their phenotypic characteristics., To meet cross-cutting secondary objectives: - Measurement of [68Ga] Ga-FAPI PET/CT fixation intensity and measurement of SF-36 questionnaire score, - Measurement of [68Ga] Ga-FAPI PET/CT fixation intensity and measurement of global disease assessment.

Source: https://euclinicaltrials.eu/ctis-public/view/2023-508190-84-01